EU clinical trial 2023-510304-53-00: INFLANET - A French Network for PET imaging of neuroinflammation in MS
Sponsor: Assistance Publique Hopitaux De Paris (Hospital/Clinic/Other health care facility). Phase: Phase II and Phase III (Integrated). Countries: France (ongoing, recruiting).
Therapeutic area(s): Diseases [C] - Nervous System Diseases [C10]
Gender: Female, Male. Age: 18-64 years. Enrolment: 50.
Status: Ongoing, recruiting. Start date (EU): 2025-12-16. Decision date: 2024-05-30. Results received: No. Last updated: 2026-06-01.

Condition(s): Multiple sclerosis
Product: 18F-DPA-714

Primary endpoint: The respective proportion of lesions classified as homogeneously active, rim active and inactive for every single patient with MS. Classification of lesions will be based on predefined data-driven threshold of activity in lesions subareas (Hamzaoui et al, 2023).
Endpoint(s): - Regional mean and voxel wise individual maps of innate immune cells activation derived from baseline [18F]-DPA-714 PET : they will be expressed as mean DVR values and as percentage of voxel classified as “DPA+”, for each region of interest: whole brain, NAWM, grey matter, cortex, thalami, deep grey matter, white matter T2 lesions, white matter T1 lesions. - Clinical and neuropsychological scores collected at baseline - An accessible pipeline for the processing of DPA-714 data - MRI data

Source: https://euclinicaltrials.eu/ctis-public/view/2023-510304-53-00